EU clinical trial 2023-506174-12-00: A 52-week, Phase 1 Safety, Pharmacokinetic and Pharmacodynamic Study of Siplizumab in Newly Diagnosed Adult Amyotrophic Lateral Sclerosis (ALS) Patients (AURORA)
Protocol code: TCD601H101
Sponsor: Itb-Med AB (Pharmaceutical company). Phase: Human Pharmacology (Phase I)- Other. Countries: Sweden (ended), Germany (ended).
Therapeutic area(s): Diseases [C] - Nervous System Diseases [C10]
Gender: Female, Male. Age: 18-64 years, 65+ years. Enrolment: 107.
Status: Ended. Start date (EU): 2025-11-06. End date (EU): 2026-07-02. Decision date: 2023-12-14. Results received: No. Last updated: 2026-06-11.
Decision dates by country: SE: 2023-12-14, DE: 2026-06-11

Condition(s): Amyotrophic Lateral Sclerosis

Source: https://euclinicaltrials.eu/ctis-public/view/2023-506174-12-00